EU clinical trial 2023-504599-10-00: A Multicenter, Open-Label, Phase 2 Study to Evaluate the Efficacy and Safety of VenetoclaxObinutuzumab Retreatment in Patients with Recurring Chronic Lymphocytic Leukemia
Protocol code: M20-356
Sponsor: AbbVie Deutschland GmbH & Co. KG (Pharmaceutical company). Phase: Therapeutic exploratory (Phase II). Countries: Spain (authorised, recruiting), Italy (ongoing, recruiting), Romania (ongoing, recruiting), Austria (ongoing, recruiting), Germany (ongoing, recruiting), Bulgaria (ongoing, recruiting).
Therapeutic area(s): Diseases [C] - Hemic and Lymphatic Diseases [C15]
Gender: Female, Male. Age: 18-64 years, 65+ years. Enrolment: 44.
Start date (EU): 2022-03-29. Decision date: 2023-11-07. Results received: No. Last updated: 2026-07-10.
Decision dates by country: RO: 2023-11-10, DE: 2023-11-29, IT: 2023-11-08, BG: 2023-12-12, ES: 2023-11-07, AT: 2023-11-13

Condition(s): Chronic lymphocytic leukemia recurrent
Product: Venetoclax, Gazyvaro 1,000 mg concentrate for solution for infusion., Venetoclax, Venetoclax

Primary endpoint: The primary efficacy endpoint is the overall response of CR, CRi, nPR, or PR in Cohort 1 subjects as assessed by the investigator at the EOCT, evaluated 3 months after the EOCT with VenG (EOCT + 3, i.e., Cycle 9)., Disease assessments will be based on the 2018 International Workshop for Chronic Lymphocytic Leukemia criteria for tumor response., Overall response rate is defined as the proportion of subjects achieving a best response of CR, CRi, nPR, or PR.
Endpoint(s): Overall response of CR or CRi at end of treatment assessment (EOT, assessed at EOT + 3), Overall response of CR, CRi, nPR, or PR at EOT (assessed at EOT + 3), Time to response (TTR), Duration of response (DOR), Time to next treatment (TTNT) for CLL, Progression-free survival (PFS), Overall survival (OS), uMRD rate (< 10-4) at EOCT, measured in PB (assessed at EOCT+ 3), uMRD rate (< 10-4) at EOT, measured in PB (assessed at EOT + 3)

Source: https://euclinicaltrials.eu/ctis-public/view/2023-504599-10-00